EU clinical trial 2022-502348-11-00: A Study of PF-08046049/SGN-BB228 in Advanced Melanoma and Other Solid Tumors
Protocol code: C5871001/SGNBB228100
Sponsor: Seagen Inc. (Pharmaceutical company). Phase: Human Pharmacology (Phase I)- First administration to humans. Countries: France (ended), Italy (ended), Germany (ended).
Therapeutic area(s): Diseases [C] - Digestive System Diseases [C06]; Diseases [C] - Respiratory Tract Diseases [C08]; Diseases [C] - Skin and Connective Tissue Diseases [C17]; Diseases [C] - Neoplasms [C04]
Gender: Female, Male. Age: 18-64 years, 65+ years. Enrolment: 45.
Status: Ended. Start date (EU): 2023-12-15. End date (EU): 2025-03-17. End date: 2026-06-01. Decision date: 2023-08-08. Results received: No. Last updated: 2025-04-01.
Decision dates by country: DE: 2023-08-10, FR: 2023-08-11, IT: 2023-08-08

Condition(s): Pancreatic Neoplasms, Colorectal Neoplasms, Non-small Cell Lung Cancer, Mesothelioma, Cutaneous Melanoma

Source: https://euclinicaltrials.eu/ctis-public/view/2022-502348-11-00